EU clinical trial 2023-510488-36-01: PsyPal; Psilocybin Therapy for Psychological Distress in Palliative Patients
Protocol code: 18870
Sponsor: Universitair Medisch Centrum Groningen (Hospital/Clinic/Other health care facility). Phase: Therapeutic exploratory (Phase II). Countries: Portugal (ongoing, recruiting), Czechia (ongoing, recruiting), Netherlands (ongoing, recruiting), Denmark (authorised, recruiting).
Therapeutic area(s): Psychiatry and Psychology [F] - Mental Disorders [F03]; Diseases [C] - Nervous System Diseases [C10]; Analytical, Diagnostic and Therapeutic Techniques and Equipment [E] - Therapeutics [E02]; Psychiatry and Psychology [F] - Psychological Phenomena [F02]; Psychiatry and Psychology [F] - Behavior and Behavior Mechanisms [F01]; Diseases [C] - Musculoskeletal Diseases [C05]; Phenomena and Processes [G] - Biological Phenomena [G16]; Diseases [C] - Respiratory Tract Diseases [C08]; Diseases [C] - Pathological Conditions, Signs and Symptoms [C23]
Gender: Female, Male. Age: 18-64 years, 65+ years. Enrolment: 108.
Start date (EU): 2025-06-01. Decision date: 2024-11-20. Results received: No. Last updated: 2026-06-17.
Decision dates by country: NL: 2024-11-25, DK: 2024-11-20, CZ: 2024-11-20, PT: 2024-11-25

Condition(s): Chronic obstructive pulmonary disease (COPD), amyotrophic lateral sclerosis (ALS), multiple sclerosis (MS), and atypical Parkinson disorder (APD), particularly multiple system atrophy (MSA), progressive supranuclear palsy (PSP), and corticobasal syndrome (CBS).
Product: Psilocybin capsules 25 mg, Psilocybin capsules 1 mg, Psilocybin capsules 15 mg

Primary endpoint: The primary endpoint is the change in depressive symptoms from baseline to 6 weeks after the second dose of psilocybin (high dose session) compared low-dose control..
Endpoint(s): To assess change in clinical functioning, end-of-life anxiety, psychological/existential distress, health-related quality of life, and how it impacts caregiver ’s health- and economic burden.

Source: https://euclinicaltrials.eu/ctis-public/view/2023-510488-36-01